EU clinical trial 2024-517198-26-00: CBD-ESPRIT - Enhancing recovery in early schizophrenia – a multi-center, two-arm, double-blind, randomized clinical trial investigating cannabidiol vs. placebo as an add-on to an individualized antipsychotic treatment
Protocol code: CBD-ESPRIT
Sponsor: Zentralinstitut Fuer Seelische Gesundheit (Hospital/Clinic/Other health care facility). Phase: Therapeutic exploratory (Phase II). Countries: Germany (temporarily halted).
Therapeutic area(s): Psychiatry and Psychology [F] - Mental Disorders [F03]
Gender: Female, Male. Age: 18-64 years, 65+ years. Enrolment: 180.
Status: Temporarily halted. Start date (EU): 2017-02-17. Decision date: 2024-11-13. Results received: No. Last updated: 2024-11-13.

Condition(s): Remitted early phase schizophrenia
Product: Cannabidiol Capsules, Füllstoffmischung DAC in hardshell gelatine capsules, size 1, is used as placebo. Füllstoffmischung DAC consists of mannitol 99.5 % and silloidal silicon dioxide (Aerosil®) 0.5 %.

Primary endpoint: All-cause discontinuation within 12 months following randomization as defined by any of the following conditions: 1) relevant worsening of symptoms; 2) not taking medication as prescribed for more than 14 consecutive days; 3) not keeping appointments as scheduled for more than six weeks; 4) not being traceable despite extensive efforts; withdrawal of informed consent; 6) termination of treatment on investigators request due to clinical reasons
Endpoint(s): Improvement in Psychopathology from baseline (PANSS, CGI, BSI-53, FROGS), social and occupational functioning (GAF, PSP) and quality of life (WHOQUOL-Bref, LQLP)., Changes from baseline in the Calgary Depression Scale for Schizo-phrenia (CDSS)., Changes from baseline in Neurocognition., Drug Attitude Inventory (DAI) and self-reported treatment adherence., Changes of cumulative dose of concomitant or rescue medication., Changes of biomarkers: alteration in endogenous cannabinoids and lipidomic profiling., Changes from baseline in the UKU Side Effect Rating Scale, Abnormal Involuntary Movement Scale (AIMS) and evaluation of ex-trapyramidal symptoms (EPS)., Columbia Suicidality Severity Rating Scale (C-SSRS)., Other safety and tolerability assessments including (S)AEs, physical examination, abdominal girth, body mass index (BMI), vital signs (including heart rate and systolic and diastolic blood pressure in both supine and standing positions), ECG, assessments for neurological functioning and detailed laboratory assessments.

Source: https://euclinicaltrials.eu/ctis-public/view/2024-517198-26-00